EU clinical trial 2024-512586-13-00: Study to Evaluate Adverse Events, Change in Disease Activity, and How Intravenously Infused ABBV-291 Moves Through the Body in Adult Participants With Non-Hodgkin's Lymphoma
Protocol code: M24-893
Sponsor: AbbVie Deutschland GmbH & Co. KG (Pharmaceutical company). Phase: Human Pharmacology (Phase I)- First administration to humans. Countries: Spain (ended), Denmark (ended), Sweden (ended).
Therapeutic area(s): Diseases [C] - Neoplasms [C04]
Gender: Female, Male. Age: 18-64 years, 65+ years. Enrolment: 56.
Status: Ended. End date (EU): 2025-09-22. Decision date: 2025-08-11. Results received: No. Last updated: 2025-08-11.
Decision dates by country: DK: 2025-08-11, ES: 2025-08-11, SE: 2025-08-11

Condition(s): Non-Hodgkin's Lymphoma

Source: https://euclinicaltrials.eu/ctis-public/view/2024-512586-13-00